EU clinical trial 2023-505962-28-00: First-line cryoablation for early treatment of Persistent Atrial Fibrillation – a randomized study comparing early trigger isolation using the Cryoballoon versus antiarrhythmic medication
Protocol code: CryoStopPersAF
Sponsor: Region Oerebro Laen, Gottsegen National Cardiovascular Center, Národny ustav srdcovych a cievnych chorob a.s., University Of Pecs (Hospital/Clinic/Other health care facility, Hospital/Clinic/Other health care facility, Hospital/Clinic/Other health care facility, Educational Institution). Phase: Therapeutic confirmatory (Phase III). Countries: Sweden (ongoing, recruiting), Hungary (authorised, recruitment pending), Slovakia (authorised, recruitment pending), Norway (ongoing, recruiting), Germany (authorised, recruitment pending), Denmark (authorised, recruitment pending), Bulgaria (authorised, recruitment pending).
Therapeutic area(s): Diseases [C] - Cardiovascular Diseases [C14]
Gender: Female, Male. Age: 18-64 years, 65+ years. Enrolment: 226.
Start date (EU): 2024-05-08. Decision date: 2023-07-04. Results received: No. Last updated: 2026-03-18.
Decision dates by country: HU: 2025-06-20, SK: 2024-08-05, NO: 2024-07-10, BG: 2025-09-29, DK: 2025-05-20, SE: 2023-07-04, DE: 2025-08-04

Condition(s): Persistent symptomatic atrial fibrillation
Product: SOTALOL, PROPAFENONE, FLECAINIDE, DRONEDARONE

Primary endpoint: The primary endpoint is freedom from atrial tachyarrhythmia recurrence lasting ≥ 6 minutes (in the absence of AAD in ablation group) as documented by 12-lead ECG, ECG rhythm strip, Holter, or an ICM, from initiation of treatment excluding the first 3 months (blanking period) to 12 months post after initiation of allocated treatment.
Endpoint(s): Compare the effect of the two first-line treatment strategies with respect to total atrial arrhythmia burden (% time in AF/AT) at 12, 24, and 36 months., Compare the effect of the two first-line treatment strategies with respect to AF progression and reversion as measured by combination of reduced number of AF progressions or increased number of AF reversions after 3 months blanking. Progression or transition to more severe AF forms such as longstanding persistent or permanent AF and AF regression as going in the opposite direction from persistent to paroxysmal to sinus rhythm at 12, 24 and 36 months., Compare the effect of the two first-line treatment strategies with respect to healthcare utilization for cardiovascular reasons (number of cardioversions, ablations, AAD initiations, cardiovascular hospitalizations, emergency department visits and unplanned outpatient visits after 3 months blanking) and its relation to AF burden., Compare the effect of the two first-line treatment strategies with respect to health care costs at 36 months., Compare the effect of the two first-line treatment strategies with respect to single and multiple procedure success (freedom from ECG documented atrial tachyarrhythmia after the 1st and last ablation procedure respectively) at 12, 24, and 36 months., Compare the effect of the two first-line treatment strategies with respect to frequency and type of adverse events, recorded continuously and classified whether related to treatment, and whether serious., Compare the effect of the two first-line treatment strategies with respect to frequency of withdrawals / 'cross-overs' over time., Compare the effect of the two first-line treatment strategies with respect to Quality of Life measured by SF-36, EQ-5D and AFSS as change from baseline to each of months 12, 24, and 36 months. The rhythm and pulse at the time of the evaluation will be recorded., Compare the effect of the two first-line treatment strategies with respect to EHRA Symptom Classification, assessed as change from baseline to each of months 12, 24, and 36 months., Compare the effect of the two first-line treatment strategies with respect to cognitive function as measured by Trail Making Test A and B from baseline to each of months 12, 24, and 36 months. The rhythm and pulse at the time of the evaluation will be recorded., Compare the effect of the two first-line treatment strategies with respect to blood pressure, systolic and diastolic (mmHg) after 10 minutes rest at baseline compared to each of months 12, 24, and 36 months. The rhythm and pulse at the time of the evaluation will be recorded., Compare the effect of the two first-line treatment strategies with respect to covariate adjusted primary endpoint (analysis using following covariates at baseline: coronary artery disease, hypertension, LAVI)., Compare the effect of the two first-line treatment strategies with respect to reverse atrial remodeling assessed by P wave variables from ECG (P-wave duration), biomarkers (NT pro-BNP, IL6, D-dimer), and left atrial size and function (LAVI, ejection fraction, atrial strain) by echocardiography, corrected for BSA, at 12, 24 and 36 months.

Source: https://euclinicaltrials.eu/ctis-public/view/2023-505962-28-00